EU clinical trial 2024-519618-29-00: A study to test Aumolertinib in European participants with genetically linked advanced Lung Cancer
Protocol code: HS-10296-108
Sponsor: Jiangsu Hansoh Pharmaceutical Group Co. Ltd. (Pharmaceutical company). Phase: Human Pharmacology (Phase I)- Other. Countries: Bulgaria (ended).
Therapeutic area(s): Diseases [C] - Neoplasms [C04]
Gender: Female, Male. Age: 18-64 years, 65+ years. Enrolment: 3.
Status: Ended. Start date (EU): 2025-04-08. End date (EU): 2025-07-18. Decision date: 2025-03-27. Results received: No. Last updated: 2025-08-14.

Condition(s): Non-Small Cell Lung Cancer (NSCLC) with Epidermal Growth Factor Receptor (EGFR) mutations, Non-Small Cell Lung Cancer (NSCLC) with Epidermal Growth Factor Receptor (EGFR) mutations

Source: https://euclinicaltrials.eu/ctis-public/view/2024-519618-29-00